EU clinical trial 2025-520979-13-00: NoLEEta - No chemotherapy in intermediate-risk HR+ HER2- early breast cancer treated with Ribociclib (LEE-011) in the adjuvant setting, a noninferiority Phase III trial
Protocol code: UC-BCG-2501
Sponsor: Unicancer (Hospital/Clinic/Other health care facility). Phase: Therapeutic confirmatory (Phase III). Countries: Germany (ongoing, recruiting), Spain (ongoing, recruiting), Netherlands (authorised, recruiting), France (ongoing, recruiting), Italy (authorised, recruiting).
Therapeutic area(s): Diseases [C] - Neoplasms [C04]
Gender: Female. Age: 18-64 years, 65+ years. Enrolment: 3306.
Start date (EU): 2025-12-18. Decision date: 2025-11-17. Results received: No. Last updated: 2026-04-15.
Decision dates by country: IT: 2025-11-19, ES: 2025-11-20, NL: 2025-11-17, DE: 2025-11-19, FR: 2025-11-17

Condition(s): Patients with HR+ HER2- early breast cancer at intermediate risk of recurrence and eligible for adjuvant chemotherapy
Product: PACLITAXEL, LEUPRORELIN, GOSERELIN, TRIPTORELIN, EPIRUBICIN, TRIPTORELIN, EXEMESTANE, RIBOCICLIB, CYCLOPHOSPHAMIDE, LETROZOLE, DOXORUBICIN, GOSERELIN, LEUPRORELIN, ANASTROZOLE, PACLITAXEL ALBUMIN-BOUND, DOCETAXEL

Primary endpoint: Invasive breast cancer-free survival according to the STEEP criteria is defined as the time from the date of randomization to the date of the first event of invasive ipsilateral breast tumor recurrence, local-regional invasive recurrence, distant recurrence, death (any cause) or invasive contralateral breast cancer as assessed by investigator. iBCFS will be censored if no iBCFS event is observed prior to the analysis cut-off date.
Endpoint(s): iDFS, DDFS, and OS according to STEEP criteria (Tolaney et al., JCO 2021)., Type of iBCFS event, AEs (adverse events) focusing on grade ≥2 according to NCI CTCAE v5.0., Change from baseline in EORTC QLQ-C30 and EORTC QLQ-BR42 questionnaires scores.

Source: https://euclinicaltrials.eu/ctis-public/view/2025-520979-13-00